EU clinical trial 2025-521026-15-00: Personalized Treatment for Endometriosis: A Study on the Safety and Kinetics of Dienogest in Women with Different Gene Variants
Protocol code: PriMEPGx-CYP3A4-Dien
Sponsor: Fundacion Para La Investigacion Biomedica Del Hospital Universitario La Princesa (Laboratory/Research/Testing facility). Phase: Human Pharmacology (Phase I)- Other. Countries: Spain (authorised, recruiting).
Therapeutic area(s): Phenomena and Processes [G] - Metabolism [G03]; Phenomena and Processes [G] - Reproductive and Urinary Physiological Phenomena [G08]
Gender: Female. Age: 18-64 years. Enrolment: 48.
Status: Authorised, recruiting. Start date (EU): 2025-12-11. Decision date: 2025-03-18. Results received: No. Last updated: 2026-03-30.

Condition(s): Healthy volunteers

Source: https://euclinicaltrials.eu/ctis-public/view/2025-521026-15-00